EU clinical trial 2023-506295-26-00: Evolution of proteinuria in renal transplant patients treated with Dapagliflozin for nephroprotection. DAPAGREFFE
Protocol code: RECHMPL23_0102
Sponsor: Centre Hospitalier Universitaire De Montpellier (Hospital/Clinic/Other health care facility). Phase: Therapeutic use (Phase IV). Countries: France (ended).
Therapeutic area(s): Phenomena and Processes [G] - Reproductive and Urinary Physiological Phenomena [G08]
Gender: Female, Male. Age: 18-64 years, 65+ years. Enrolment: 70.
Status: Ended. Start date (EU): 2023-12-27. End date (EU): 2025-10-28. Decision date: 2023-10-13. Results received: No. Last updated: 2026-02-27.

Condition(s): chronic renal failure
Product: Forxiga 10 mg film-coated tablets

Primary endpoint: Decrease in albuminuria/creatinuria ratio ≥ 50% from baseline or achievement of albuminuria/creatinuria ratio ≤ 30 mg/g at 6 months after introduction of dapagliflozin
Endpoint(s): Decrease in albuminuria/creatinuria ratio ≥ 50% from baseline or achievement of albuminuria/creatinuria ratio ≤ 30 mg/g, 3 months after introduction of dapagliflozin, Decrease ≥ 50% in GFR from baseline to M3 et M6, Number of patients with end-stage CKD as defined by dialysis or pre-emptive transplant replacement therapy at M6, Numbers of episodes of acute renal failure defined according to KDIGO criteria (stage I: increase in serum creatinine ≥ 26.52 micromoles/L in 48 hours or increase in serum creatinine of ≥ 1.5 times the initial value in the preceding 7 days, stage II: increase in serum creatinine ≥ 2 times the initial value, stage III: increase in serum creatinine ≥ 3 times the initial value or serum creatinine ≥ 353. 6 mmol/l or need to start extrarenal purification at M3 and M6, Death rate from any cause, Study of interaction with immunosuppressive treatments (residual rate and change in dosage of immunosuppressive treatment) at M3 and M6, Changes in blood pressure, weight and Hba1c from baseline to M3 et M6, Occurrence of infectious side effects, including urinary tract infections, genital mycotic infections, Fournier's gangrene at M3 and M6, Occurrence of metabolic side effects including diabetic ketoacidosis, hypoglycemia, dehydration, hypotension, hydrosodium depletion at M3 and M6, Other adverse reactions associated with dapagliflozin at M3 and M6, Discontinuation of treatment for side effects at M3 and M6

Source: https://euclinicaltrials.eu/ctis-public/view/2023-506295-26-00